EU clinical trial 2022-501132-42-00: Cohort study of human mpox virus disease
Sponsor: University Of Oxford (Educational Institution). Phase: Therapeutic use (Phase IV). Countries: Belgium (ended), Portugal (ended), Italy (ended), Spain (ended), Norway (ended), France (ended), Netherlands (ended), Ireland (ended).
Therapeutic area(s): Diseases [C] - Virus Diseases [C02]
Gender: Female, Male. Age: 0-17 years, 18-64 years, 65+ years. Enrolment: 800.
Status: Ended. Start date (EU): 2022-08-02. End date (EU): 2024-01-31. Decision date: 2022-07-08. Results received: Yes. Last updated: 2024-01-29.
Decision dates by country: FR: 2022-08-02, NL: 2022-08-17, NO: 2022-09-12, ES: 2022-08-03, PT: 2022-08-12, BE: 2022-08-02, IE: 2022-09-16, IT: 2022-07-08

Condition(s): Monkeypox virus disease
Product: Tecovirimat SIGA 200 mg hard capsules

Primary endpoint: Time to lesion(s) resolution, defined a.From a start point of date that positive test is collected (or that treatment started if any delayed treatment) b. Until an endpoint of up to 14 days since inclusion (or since commencement of treatment if any delayed treatment). c.Where lesion resolution is the first day on which all lesions are resorbed, scabbed or desquamated and mucosal ulcers healed. d.And the absence of any serious complications
Endpoint(s): Clinical status defined by a) Clinical status on day 14 and day 28 according to an ordinal scale assessed by a physician or a study nurse. The ordinal scale is a) all lesions resolved and no serious complications, b) one or more lesions are active and no serious complications, c) serious complication and/or hospitalization due to mpox, or d) death. b) Evidence of recrudescence or relapse at day 60 and day 180., Virological status defined by: A) Change from baseline in mpox virus DNA levels in throat swabs on days 4, 8, 14 and 28; B)Change from baseline in Monkeypox virus DNA levels in blood on days 4, 8, 14 and 28, C) Presence of Monkeypox virus DNA in lesion swabs on days 4, 8, 14 and 28., In cohort receiving tecovirimat (or other antivirals): Number and type of Serious Adverse Events (SAEs), Suspected Adverse Reactions (SARS) and Suspected Unexpected Serious Adverse Reactions, (SUSARs) within 28 days of enrolment, Outcome of pregnancy in women who are pregnant

Source: https://euclinicaltrials.eu/ctis-public/view/2022-501132-42-00